EU clinical trial 2026-525706-35-00: Relative bioavailability and effect of food study with GLPG3667 in healthy subjects
Protocol code: GLPG3667-CL-120
Sponsor: Galapagos (Pharmaceutical company). Phase: Human Pharmacology (Phase I)- Other. Countries: Belgium (authorised, recruitment pending).
Therapeutic area(s): Diseases [C] - Immune System Diseases [C20]
Gender: Female, Male. Age: 18-64 years. Enrolment: 16.
Status: Authorised, recruitment pending. Decision date: 2026-04-27. Results received: No. Last updated: 2026-04-27.

Condition(s): inflammatory and autoimmune diseases

Source: https://euclinicaltrials.eu/ctis-public/view/2026-525706-35-00